EU clinical trial 2025-524819-37-00: TheRapeutic StrAtegies for Obstructive SleeP Apnea in Older Adults with OverweigHt or Obesity: A RandomizEd Clinical TriaL (RAPHAEL study)
Protocol code: RAPHAEL
Sponsor: Institut De Recerca Biomedica De Lleida Fundacio Dr. Pifarre (Laboratory/Research/Testing facility). Phase: Therapeutic use (Phase IV). Countries: Spain (authorised, recruitment pending).
Therapeutic area(s): Diseases [C] - Respiratory Tract Diseases [C08]
Gender: Female, Male. Age: 65+ years. Enrolment: 345.
Status: Authorised, recruitment pending. Decision date: 2026-03-30. Results received: No. Last updated: 2026-03-30.

Condition(s): obstructive sleep apnea
Product: Wegovy 2.4 mg solution for injection in pre-filled pen

Primary endpoint: The change in Apnea–Hypopnea Index (AHI) at 6 months
Endpoint(s): OSA pathophysiology (hypoxic burden, delta heart rate, loop gain)., Symptoms (daytime sleepiness)., Blood pressure., Functional and psychological domains (quality of life, sleep quality, circadian rest-activity rhythm, cognitive function, mental health)., Body weight., Molecular mechanisms (biomarkers of inflammation, oxidative stress, obesity, and cardiovascular risk)., Cost-effectiveness.

Source: https://euclinicaltrials.eu/ctis-public/view/2025-524819-37-00